EU clinical trial 2024-515624-36-00: Inmmunotherapy with peripheral blood, autologous, a dult T cells, expanded and transduced (gene modified) with a lentiviral vector expressing an anti-CD30-chimeric antigen receptor with 4-1-BB and CD3z costimulatory sequences in patients with Classical Hodgkin lymphoma and non-Hodgkin CD30+ T cell lymphoma.
Sponsor: Fundacio Institut De Recerca De L'Hospital De La Santa Creu I Sant Pau (Hospital/Clinic/Other health care facility). Phase: Phase I and Phase II (Integrated)- First administration to humans. Countries: Spain (ongoing, recruitment ended).
Therapeutic area(s): Diseases [C] - Neoplasms [C04]
Gender: Female, Male. Age: 18-64 years, 65+ years. Enrolment: 40.
Status: Ongoing, recruitment ended. Start date (EU): 2024-12-17. Decision date: 2024-12-17. Results received: No. Last updated: 2025-08-29.

Condition(s): Refractary or relapse non-Hodgkin T CD30+ lymphoma., Refractary or relapse Hodgkin T CD30+ lymphoma
Product: Fludarabina Accord 25 mg/ml concentrado para solución inyectable y para perfusión., HSP-CAR30, Levact 2,5 mg/ml poudre pour solution à diluer pour perfusion, RoActemra 20 mg/mL concentrate for solution for infusion, Genoxal 200 mg polvo para solución inyectable y para perfusión

Primary endpoint: Dose-limiting toxicity (DLT): the proportion of patients with DLT in the first month after infusion of HSP-CAR30 cells will be calculated, for each dose, together with the 95% confidence interval., Safety: Data on the type and frequency of AEs will be collected for each dose level, starting from the infusion of HSP-CAR30 cells and up to 30 days thereafter., Answer: the percentage of responses (RC, RP and RG) will be analyzed according to RECIL 2017 criteria and its 95% confidence interval will be calculated. Only patients who receive the infusion of HSP-CAR30 cells will be evaluable for response. In no case will patients who do not present detectable disease by PET-CT (patient in CR), determined in the 30 days prior to the infusion of HSPCAR30 cells, be considered for response analysis.

Source: https://euclinicaltrials.eu/ctis-public/view/2024-515624-36-00